EU clinical trial 2025-523797-17-00: A Multicenter, Randomized, Double-Blinded, Placebo-Controlled, Dose-Range Finding Study of ORKA-001 in Participants with Moderate-to-Severe Plaque Psoriasis
Protocol code: ORKA-001-114
Sponsor: Oruka Therapeutics Inc. (Pharmaceutical company). Phase: Therapeutic exploratory (Phase II). Countries: Germany (ongoing, recruitment ended), Spain (ongoing, recruitment ended).
Therapeutic area(s): Diseases [C] - Skin and Connective Tissue Diseases [C17]
Gender: Female, Male. Age: 18-64 years, 65+ years. Enrolment: 32.
Status: Ongoing, recruitment ended. Start date (EU): 2026-05-08. Decision date: 2026-05-08. Results received: No. Last updated: 2026-05-11.
Decision dates by country: DE: 2026-05-08, ES: 2026-05-11

Condition(s): Moderate-to-Severe Plaque Psoriasis
Product: ORKA-001, Placebo for ORKA-001

Primary endpoint: Proportion of Participants Achieving 100% Reduction in PASI Score at Week 16: The Psoriasis Area and Severity Index Score (PASI) is an evaluation tool that combines the assessment of the severity and the area affected by psoriasis into a single score ranging from 0 (no disease) to 72 (maximum disease) (Time Frame: Week 16)
Endpoint(s): Proportion of Participants Who Achieve an IGA = 0 (Clear) at Week 16: The Investigator Global Assessment (IGA) documents the Investigator’s assessment of the participant’s psoriasis at a given time point. Overall lesions are graded for induration, erythema, and scaling. The participant’s psoriasis is assessed as clear (0), almost clear (1), mild (2), moderate (3), or severe (4). (Time Frame: Week 16), Proportion of Participants Achieving 90% Reduction in PASI Score at Week 16 (Time Frame: Week 16), Proportion of Participants Who Achieve an IGA = 0 (Clear) or 1 (Almost Clear) at Week 16 (Time Frame: Week 16), Proportion of Participants Maintaining 100% Reduction in PASI Score at Week 100 (Time Frame: Week 100), Proportion of Participants Maintaining an IGA = 0 (Clear) at Week 100 (Time Frame: Week 100), Proportion of Participants Maintaining 90% Reduction in PASI Score at Week 100 (Time Frame: Week 100), Proportion of Participants Maintaining an IGA = 0 (Clear) or 1 (Almost Clear) at Week 100 (Time Frame: Week 100), Proportion of Participants Maintaining 75% Reduction in PASI Score at Week 100 (Time Frame: Week 100), Incidence of Treatment-emergent Adverse Events (TEAEs) and TEAEs of Special Interest (TEAESIs): Incidence of treatment adverse events, treatment adverse events of special interest, and clinically significant changes from baseline in vital signs, clinical laboratory parameters and electrocardiograms. (Time Frame: Day 1 through Week 100)

Source: https://euclinicaltrials.eu/ctis-public/view/2025-523797-17-00